EU clinical trial 2024-511917-40-00: A Phase 2 Trial to Evaluate the Safety and Efficacy of Combination Therapies in Patients with Advanced Upper Gastrointestinal Tract Malignancies (EDGE-Gastric)
Protocol code: ARC-21(EDGE-Gastric)
Sponsor: Arcus Biosciences Inc. (Pharmaceutical company). Phase: Therapeutic exploratory (Phase II). Countries: France (ended).
Therapeutic area(s): Diseases [C] - Neoplasms [C04]
Gender: Female, Male. Age: 18-64 years, 65+ years. Enrolment: 60.
Status: Ended. Start date (EU): 2022-09-13. End date (EU): 2026-07-10. Decision date: 2024-11-28. Results received: No. Last updated: 2026-05-28.

Condition(s): Advanced Upper Gastrointestinal Tract Malignancies, Gastrointestinal Tract Malignancies, Upper Gastrointestinal Tract Cancer
Product: OXALIPLATIN, CALCIUM FOLINATE, FLUOROURACIL, Quemliclustat, Zimberelimab, DOMVANALIMAB

Primary endpoint: The Incidence and severity of adverse events (AEs), serious adverse events (SAEs), and any Clinically meaningful trends in safety parameters [Time Frame: Up to 18 months], Objective Response Rate (ORR) as measured by Response Evaluation Criteria in Solid Tumors (RECIST) v1.1 and assessed by the investigator [Time Frame: Up to 18 months]
Endpoint(s): Objective Response Rate (ORR) as measured by PD-L1 Expression Level [Time Frame: Up to 18 months], Overall survival (OS) [Time Frame: From date of first dose until the date of death due to any cause (approximately 18 months)], Progression-free survival (PFS) as determined by the Investigator according to RECIST v1.1 [Time Frame: Up to 18 months], Disease Control (complete response, partial response, or stable disease) for greater than equal to 12 weeks [Time Frame: Up to 18 months], Duration of response (DOR) as determined by the Investigator according to RECIST v1.1 [Time Frame: Up to 18 months], Plasma concentration of domvanalimab [Time Frame: Up to 18 months], Plasma concentration of zimberelimab [Time Frame: Up to 18 months], Plasma concentration of quemliclustat [Time Frame: Up to 18 months], Percentage of participants with anti-drug antibodies to domvanalimab [Time Frame: Up to 18 months], Percentage of participants with anti-drug antibodies to zimberelimab [Time Frame: Up to 18 months]

Source: https://euclinicaltrials.eu/ctis-public/view/2024-511917-40-00